EU clinical trial 2026-526038-26-00: A Study to Learn About How Different Forms of Study Medicine Prifetrastat are Taken Up Into the Blood in Healthy Adults
Protocol code: C4551017
Sponsor: Pfizer Inc. (Pharmaceutical company). Phase: Human Pharmacology (Phase I)- Other. Countries: Belgium (ongoing, recruiting).
Therapeutic area(s): Diseases [C] - Neoplasms [C04]
Gender: Female, Male. Age: 18-64 years, 65+ years. Enrolment: 32.
Status: Ongoing, recruiting. Start date (EU): 2026-07-08. Decision date: 2026-06-17. Results received: No. Last updated: 2026-07-08.

Condition(s): Locally advanced or metastatic ER+/HER2- breast cancer

Source: https://euclinicaltrials.eu/ctis-public/view/2026-526038-26-00